EU clinical trial 2025-524901-33-00: Use of half the iodinated contrast medium for monitoring thoracic neoplasms using spectral CT: Randomized, crossover, non-inferiority clinical trial
Sponsor: Fundacion De La Comunitat Valenciana Para La Gestion Del Instituto De Investigacion Sanitaria Y Biomedica De Alicante (Laboratory/Research/Testing facility). Phase: Therapeutic use (Phase IV). Countries: Spain (authorised, recruitment pending).
Therapeutic area(s): Analytical, Diagnostic and Therapeutic Techniques and Equipment [E] - Diagnosis [E01]
Gender: Female, Male. Age: 18-64 years, 65+ years. Enrolment: 52.
Status: Authorised, recruitment pending. Decision date: 2026-03-17. Results received: No. Last updated: 2026-03-17.

Condition(s): Thoracic neoplasm
Product: Iomeron 400 mgI/ml solution for injection

Primary endpoint: Vascular attenuation and signal-to-noise ratio., Hepatic attenuation and signal-to-noise ratio., Subjective assessment of overall image quality and image noise.
Endpoint(s): To analyze the agreement between two readers in the assessment of the evaluated parameters.

Source: https://euclinicaltrials.eu/ctis-public/view/2025-524901-33-00